EU clinical trial 2025-522263-14-00: A Phase 2/3 Randomized, Double Blind, Placebo-Controlled, Dose Ranging Study to Evaluate the Pharmacodynamics, Safety and Efficacy of SKY-0515 in Participants with Huntington’s Disease
Protocol code: SKY-0515-004-WW
Sponsor: Skyhawk Therapeutics Inc. (Pharmaceutical company). Phase: Phase II and Phase III (Integrated). Countries: Germany (authorised, recruitment pending), Spain (authorised, recruitment pending).
Therapeutic area(s): Diseases [C] - Nervous System Diseases [C10]
Gender: Female, Male. Age: 18-64 years, 65+ years. Enrolment: 110.
Status: Authorised, recruitment pending. Decision date: 2026-07-23. Results received: No. Last updated: 2026-07-29.
Decision dates by country: DE: 2026-07-23, ES: 2026-07-29

Condition(s): Huntington’s Disease
Product: SKY-0515 9 mg tablet, Micronized methylcellulose spray-dried intermediate in enteric-coated tablets, SKY-0515 4 mg tablet, SKY-0515 6 mg tablet

Primary endpoint: Change from baseline to Week 72 in cUHDRS.
Endpoint(s): Change from baseline to Week 72 in: − Total motor score (TMS) − Total functional capacity (TFC) − Independence scale (IS) − Stroop Color and Word test (SCWT) − Symbol digital modalities test (SDTM)

Source: https://euclinicaltrials.eu/ctis-public/view/2025-522263-14-00